EU clinical trial 2024-511801-51-00: SPOTLIGHT 204: A Multicenter, Phase 2b, open-label, non-randomized, clinical trial to evaluate safety, tolerability and preliminary efficacy of intra-lesional BO-112 in patients with resectable primary low and high risk basal cell carcinoma
Protocol code: BOT-112-204
Sponsor: Highlight Therapeutics S.L. (Pharmaceutical company). Phase: Therapeutic exploratory (Phase II). Countries: Spain (ongoing, recruitment ended).
Therapeutic area(s): Diseases [C] - Skin and Connective Tissue Diseases [C17]
Gender: Female, Male. Age: 18-64 years, 65+ years. Enrolment: 30.
Status: Ongoing, recruitment ended. Start date (EU): 2024-10-24. Decision date: 2024-08-12. Results received: No. Last updated: 2026-04-16.

Condition(s): Basal cell carcinoma
Product: BO-112

Primary endpoint: Composite visual and pathological response [at surgery] on patient level assessed by central review
Endpoint(s): Occurrence of adverse events (AEs), serious adverse events (SAEs), and AEs leading to discontinuation or death on patient level, Pathological response [at surgery] on patient level assessed by the investigator and central review, respectively. Visual response [during the study and at surgery] on patient level assessed by the investigator and central review, respectively., Recurrence [at 12 months] after surgery on patient level assessed by the investigator

Source: https://euclinicaltrials.eu/ctis-public/view/2024-511801-51-00